EU clinical trial 2024-511900-17-00: Dose dense re-challenge of high dose methotrexate (hd-mtx) with glucarpidase (cpg2) for relapsed primary cns lymphoma (pcnsl): A phase 1 trial (METHOGLU)
Sponsor: Assistance Publique Hopitaux De Paris (Hospital/Clinic/Other health care facility). Phase: Human Pharmacology (Phase I)- Other. Countries: France (authorised, recruiting).
Therapeutic area(s): Diseases [C] - Neoplasms [C04]
Gender: Female, Male. Age: 18-64 years, 65+ years. Enrolment: 22.
Status: Authorised, recruiting. Start date (EU): 2025-02-14. Decision date: 2024-10-29. Results received: No. Last updated: 2026-04-02.

Condition(s): Oncology: RELAPSED PRIMARY CNS LYMPHOMA

Source: https://euclinicaltrials.eu/ctis-public/view/2024-511900-17-00